EU clinical trial 2024-514457-30-00: Combining Clemastine and Aerobic Exercise to Treat Cognitive Dysfunction in Schizophrenia by Targeting Myelin Plasticity (OligoTreat)
Sponsor: Klinikum der Universitaet Muenchen AöR (Hospital/Clinic/Other health care facility). Phase: Therapeutic exploratory (Phase II). Countries: Germany (ongoing, recruiting).
Therapeutic area(s): Psychiatry and Psychology [F] - Mental Disorders [F03]
Gender: Female, Male. Age: 18-64 years, 65+ years. Enrolment: 90.
Status: Ongoing, recruiting. Start date (EU): 2024-02-26. Decision date: 2024-08-26. Results received: No. Last updated: 2024-08-26.

Condition(s): Schizophrenia
Product: Tavegil Tabletten, P-Tabletten weiß 7 mm Lichtenstein

Primary endpoint: Absolute change in working memory performance assessed by the nback test (2-back, d-prime) after 90-93 days of treatment., Absolute change in GAF score after 90-93 days of treatment.
Endpoint(s): Change in total PANSS scores at V2 compared to baseline, Change in Clinical Global Impression (CGI) rating scale at V2 compared to baseline, Change in remission criteria ("Andreasen Remission criteria") status from V2 compared to baseline, Change in GAF and n-back scores (2-back, d-prime) from V3 compared to V2, Change in Calgary Depression Scale for Schizophrenia (CDSS) score at V2 compared to baseline, Change in World Health Organization Quality of Life Brief Version (WHO-QOL-BREF) at V2 compared to baseline, Change in verbal memory and fluency, motor speed, attention, speed of information processing, working memory, executive functions, and global cognition according to the Brief Assessment of Cognition in Schizophrenia (BACS) and change in attention span and executive functions in the Trail Making Test (TMT) A & B at V2 compared to baseline, Change in Physical fitness at V2 compared to baseline: Physical working capacity (PWC130: power [W] at a heart rate of 130 beats per minute, power [W] at fixed values of lactate concentrations), Change in weight, waist-to-hip-ratio after 3 months compared to baseline, Change in Physical activity at V2 compared to baseline: Simple Physical Activity Questionnaire (SIMPAQ), actimetry., Change in 3T MRI at V2 (day 90-93): structural MRI (T1-MPRAGE, T2- SPACE), DTI, resting-state MRI and ASL, all compared to baseline, Change in shortening of P100 latency delay on VEPs at V2 compared to baseline, Change in Functional Remission of General Schizophrenia (FROGS) scale at V2 compared to baseline, Change in Fatigue Scale for Motor and Cognitive Functions (FSMC) at V2 compared to baseline, Change in Internal-External Locus of Control Scale (IE-4), Resilience (BRS), Selfefficacy (ASKU) and exercise-related selfefficacy (SSA) at V2 compared to baseline and associations to training adherence, Change in Exercise Motivations Inventory and Exercise Motives and Gains Inventory (EMI-2) at V2 compared to baseline and associations to training adherence, Associations between personality factors assessed with the BFI-10 and training adherence, Change in exploratory rating scales at V3 compared to V2, Change in Andreasen Remission criteria at the optional follow-up visit V3 compared to baseline., Side effects and safety endpoints

Source: https://euclinicaltrials.eu/ctis-public/view/2024-514457-30-00